EU clinical trial 2024-511946-38-00: Efficacy of Intrathecal Morphine for Postoperative Analgesia with or without Suprainguinal Fascia Iliaca Block After Total Hip Arthroplasty: A Double-Blind Randomized Clinical Trial
Sponsor: Centre hospitalier universitaire de Liege (Hospital/Clinic/Other health care facility). Phase: Therapeutic use (Phase IV). Countries: Belgium (ended).
Therapeutic area(s): Analytical,Diagnostic,Therapeutic Techniques and Equipment [E]-Surgical Procedures, Operative [E04]
Gender: Female, Male. Age: 18-64 years, 65+ years. Enrolment: 114.
Status: Ended. Start date (EU): 2024-06-12. End date (EU): 2025-11-06. Decision date: 2024-05-08. Results received: No. Last updated: 2024-05-08.

Condition(s): Total hip arthroplasty under spinal anesthesia
Product: MARCAINE 0,5 %, solution injectable, Linisol 1 %, solution injectable, Etoricoxib AB 60 mg comprimés pelliculés, Dafalgan Caps Forte 1 g harde capsules, Aacidexam 5 mg/ml solution injectable, MINI-PLASCO NACL B. BRAUN 0,9 %, solution injectable, MINI-PLASCO NACL B. BRAUN 0,9 %, oplossing voor injectie, NAROPIN 7,5 mg/ml, solution injectable, MORPHINE HCl STEROP 10mg/1ml Solution injectable

Primary endpoint: The primary endpoints will be dynamic NRS pain (NRS 0 to 10) at passive 90- degree flexion of the lower limb on the trunk in the supine position at 8 hours after surgery.
Endpoint(s): Total consumption of morphine equivalents during the first 48 hours post- operatively, through IV administration of morphine on a Patient Controlled Intravenous Analgesia (PCIA) device., NRS pain scores at rest and mobilization at fixed times: 8 hours after surgery, at 8:00 am, 1:00 pm and 6:00 pm on the first (D1) and second (D2) day after surgery (pain trajectory), Postoperative complications such as: orthostatic intolerance, falls and postoperative nausea and vomiting, Morphine-related side effects: bladder globe, constipation, dizziness and drowsiness, Patient's pain related experience assessed by the International Pain Outcome (IPO) questionnaire at D2, Quality-of-Recovery 15-items (QoR-15) score for assessment of functional recovery on D1, D2, day-7 (D7) and day-30 (D30)

Source: https://euclinicaltrials.eu/ctis-public/view/2024-511946-38-00